EU clinical trial 2023-508443-40-00: A Phase 3, Randomized, Double-Blind, Placebo-Controlled, Multicenter Study Comparing Niraparib Plus Pembrolizumab Versus Placebo Plus Pembrolizumab as Maintenance Therapy in Participants Whose Disease has Remained Stable or Responded to First-Line Platinum Based Chemotherapy with Pembrolizumab for Stage IIIB/IIIC or IV Non-Small Cell Lung Cancer (ZEAL 1L)
Protocol code: 213400
Sponsor: Glaxosmithkline Research & Development Limited (Pharmaceutical company). Phase: Therapeutic confirmatory (Phase III). Countries: Netherlands (ended), Poland (ended), Hungary (ended), Romania (ended), Germany (ended), Bulgaria (ended), Sweden (ended), Greece (ended), France (ended), Spain (ended), Norway (ended), Italy (ended), Belgium (ended), Ireland (ended).
Therapeutic area(s): Diseases [C] - Respiratory Tract Diseases [C08]
Gender: Female, Male. Age: 18-64 years, 65+ years. Enrolment: 363.
Status: Ended. Start date (EU): 2020-12-18. End date (EU): 2024-09-23. End date: 2026-03-24. Decision date: 2024-02-12. Results received: No. Last updated: 2026-01-09.
Decision dates by country: SE: 2024-02-13, BE: 2024-02-13, IE: 2024-02-12, GR: 2024-04-15, NO: 2024-02-16, BG: 2024-03-07, PL: 2024-02-29, FR: 2024-02-16, NL: 2024-02-12, HU: 2024-02-14, IT: 2024-02-14, DE: 2024-02-14, RO: 2024-02-19, ES: 2024-02-12

Condition(s): Lung Cancer, Non-Small Cell
Product: Niraparib Placebo Tablets, KEYTRUDA 25 mg/mL concentrate for solution for infusion

Primary endpoint: This study has dual primary efficacy endpoints: PFS and OS in overall population. The study will have met its primary objective if niraparib plus pembrolizumab is superior to placebo plus pembrolizumab for either PFS or OS at the interim or final analyses in overall population. Progression will be assessed by BICR using the RECIST v.1.1 criteria. Participants who are alive will be censored at the date of last contact.
Endpoint(s): Key secondary efficacy endpoints: PFS in NSQ population defined as per primary PFS endpoint, PFS in CR/PR population defined as per primary PFS endpoint, OS in NSQ population defined as per primary OS endpoint, OS in the CR/PR population, TTP in the CNS, which is defined as the time from the date of randomization until the earliest date of documented PD in the CNS, based on BICR assessment using RANO-BM criteria, The following secondary efficacy endpoints will be evaluated: PFS as assessed by the Investigator using RECIST v1.1, PFS, per RECIST v1.1 based on BICR, and OS by PD-L1 status (PD L1 TC <1% and NE versus ≥1%), TTD, defined as the time from randomization to meaningful deterioration on a composite endpoint of dyspnea, chest pain, and cough, on the EORTC QLQ LC13, Change from baseline in the EORTC QLQ C30 and EORTC QLQ LC13 domains, Safety Analysis Safety will be evaluated based on the incidence of AEs, SAEs, and AESIs, treatment discontinuations, dose interruptions, and dose reductions due to AEs, SAEs, or AESIs, changes in ECOG performance status, changes in clinical laboratory results, vital sign measurements, observations during physical examination, and use of concomitant medications. AEs will be coded using the current version of the MedDRA and severity of AEs will be graded by NCI‑CTCAE v5.0, PK Analysis (Secondary Endpoint) To evaluate niraparib exposure, blood samples for niraparib pharmacokinetics (PK) will be collected at the time points specified in Table 3 for all study participants with sparse PK sampling. In addition, analysis of the exposure-response relationship for niraparib may be conducted if the PK data are deemed appropriate.

Source: https://euclinicaltrials.eu/ctis-public/view/2023-508443-40-00